EU clinical trial 2024-517755-12-00: Testosterone Replacement Therapy in Women with Turner Syndrome – Endocrine, Cardiovascular, Physiological, Neurocognitive and Genomic effects
Sponsor: Region Midtjylland (Hospital/Clinic/Other health care facility). Phase: Therapeutic exploratory (Phase II). Countries: Denmark (authorised, recruiting).
Therapeutic area(s): Diseases [C] - Hormonal diseases [C19]
Gender: Female. Age: 18-64 years. Enrolment: 50.
Status: Authorised, recruiting. Start date (EU): 2026-02-26. Decision date: 2025-04-22. Results received: No. Last updated: 2026-03-23.

Condition(s): Turner Syndrome
Product: ISOPROPYL MYRISTATE, ANDROGEL 25 mg, gel transdermique, ETHANOL (96 PER CENT), CARBOMER 980, SODIUM HYDROXIDE

Primary endpoint: Changes in body composition examined by total body dual-energy x-ray absorptiometry (DXA-scan) including bone mass, visceral and subcutaneous fat mass, and lean muscle mass, as well as measures of abdominal circumference and weight.
Endpoint(s): Changes in quality of life, Changes in inflammatory markers, Changes in sexual function, Changes in intramuscular sex hormone levels, Changes in blood volume and hemoglobin mass, Changes in coagulation parameters, Changes in metabolic parameters, Changes in neurocognitive function, Changes in hypothalamus structure, Changes in VO2-max, physical activity, muscle function and strength

Source: https://euclinicaltrials.eu/ctis-public/view/2024-517755-12-00